EU clinical trial 2024-514034-20-00: A Study to Test How BI 765063 and BI 770371 Are Taken up in Tumours of People With Different Types of Advanced Cancer Who Are Also Taking Ezabenlimab
Protocol code: 1443-0003
Sponsor: Boehringer Ingelheim International GmbH (Pharmaceutical company). Phase: Human Pharmacology (Phase I)- Other. Countries: Netherlands (ongoing, recruitment ended).
Therapeutic area(s): Diseases [C] - Neoplasms [C04]
Gender: Female, Male. Age: 18-64 years, 65+ years. Enrolment: 13.
Status: Ongoing, recruitment ended. Start date (EU): 2021-11-16. Decision date: 2024-07-29. Results received: No. Last updated: 2025-08-06.

Condition(s): non-small cell lung cancer or, melanoma, head and neck squamous cell carcinoma

Source: https://euclinicaltrials.eu/ctis-public/view/2024-514034-20-00